EU clinical trial 2024-516163-88-00: Reperfusion with P2Y12 inhibitors in addition to mechanical thrombectomy for perfusion imaging selected acute stroke patients : a multicentric randomized controlled trial.
Protocol code: MMI_2020_35
Sponsor: Fondation A De Rothschild (Hospital/Clinic/Other health care facility). Phase: Phase III and phase IV (Integrated). Countries: France (ongoing, recruiting).
Therapeutic area(s): Diseases [C] - Cardiovascular Diseases [C14]
Gender: Female, Male. Age: 18-64 years, 65+ years. Enrolment: 368.
Status: Ongoing, recruiting. Start date (EU): 2024-08-01. Decision date: 2024-08-01. Results received: No. Last updated: 2026-07-09.

Condition(s): Acute ischemic stroke
Product: Kengrexal 50 mg powder for concentrate for solution for injection/infusion

Primary endpoint: Favorable functional outcome defined by a modified Rankin Scale (mRS) score ≤ 2 at 3 months.
Endpoint(s): mRS shift analysis at 3 months., a. Rate of near or complete reperfusion at end of treatment defined by modified treatment in cerebral infarction (mTICI) score 2c or 3. b. Rate of successful reperfusion at end of treatment defined by modified treatment in cerebral infarction (mTICI) score of 2b or 2c or 3., Change in NIHSS from baseline to 24 hours after treatment., Volume assessed by the ASPECTS score (Assessment in Acute Stroke Alberta Stroke Program Early CT) at 24-36 hours., Rate of all-cause mortality at 3 months., Rate of symptomatic intracranial hemorrhage according the Heidelberg definition associated to at least 4 points worsening in NIHSS at 24-36h after treatment., Rate of any intracranial hemorrhage according the Heidelberg definition at 24-36h after treatment.

Source: https://euclinicaltrials.eu/ctis-public/view/2024-516163-88-00